EU clinical trial 2023-504247-13-00: DAREON™-5: An open-label, multi-center Phase II dose selection trial of intravenous BI 764532, a DLL3-targeting T cell engager, in patients with relapsed/refractory extensive-stage small cell lung cancer and in patients with other relapsed/refractory neuroendocrine carcinomas
Protocol code: 1438-0005
Sponsor: Boehringer Ingelheim International GmbH (Industry). Phase: Therapeutic exploratory (Phase II). Countries: Spain (ongoing, recruiting), Italy (ended), Portugal (ended), Germany (ongoing, recruiting), France (ended), Bulgaria (ended), Poland (ended), Belgium (ongoing, recruiting).
Therapeutic area(s): Diseases [C] - Neoplasms [C04]
Gender: Female, Male. Age: 18-64 years, 65+ years. Enrolment: 122.
Start date (EU): 2023-10-17. Decision date: 2023-09-25. Results received: No. Last updated: 2026-06-25.
Decision dates by country: BG: 2023-10-02, IT: 2023-09-28, FR: 2023-09-28, PL: 2023-10-02, PT: 2023-09-27, BE: 2023-09-25, DE: 2023-09-28, ES: 2023-09-27

Condition(s): Small Cell Lung Cancer, Large cell neuroendocrine carcinoma, Extra-pulmonary neuroendocrine carcinoma
Product: BI 764532

Primary endpoint: Part 1: Objective response (OR), defined as a best overall response of confirmed complete response (CR) or confirmed partial response (PR) according to RECIST v 1.1 by investigator assessment from the date of treatment start until the earliest date of disease progression, death, or last evaluable tumour assessment before start of subsequent anti-cancer therapy, loss to follow-up, or withdrawal of consent., Part 1: Occurrence of treatment-emergent adverse events (TEAEs) during the on-treatment period., Part 2: Objective response (OR), defined as a best overall response of confirmed complete response (CR) or confirmed partial response (PR) according to RECIST v 1.1 by blinded independent central review from the date of treatment start until the earliest date of disease progression, death, or last evaluable tumour assessment before start of subsequent anti-cancer therapy, loss to follow-up, or withdrawal of consent., Part 3: Occurrence of treatment-emergent adverse events (TEAEs) during the on-treatment period., Objective response (OR) by blinded independent central review.
Endpoint(s): Part 1: Duration of objective response (DOR) based on investigator assessment. DOR is defined as the time from first documented confirmed OR until the earliest date of disease progression or death among patients with confirmed OR., Part 1: Progression-free survival (PFS) based on investigator assessment. PFS is defined as the time from treatment start until the earliest date of tumour progression according RECIST v 1.1 or death from any cause, whichever occurs first., Part 1: Disease control (DC), defined as best overall response of CR or PR or stable disease (SD) based on investigator assessment, where best overall response is defined according to RECIST v 1.1, from first treatment administration until the earliest of disease progression, death, or last evaluable tumour assessment before start of subsequent anti-cancer therapy, loss to follow-up or withdrawal of consent., Part 1, 2, and 3: Overall survival (OS), defined as the time from treatment start until death from any cause., Part 1, 2 y 3: The following endpoints reflecting patient-reported outcomes (PRO) will be assessed with the following PRO measures: - Change from baseline in EORTC QLQ-C30 physical functioning domain score - Change from baseline in EORTC QLQ-C30 role functioning domain score, Part 1, 2, and 3: Occurrence of treatment-emergent AEs leading to study drug discontinuation during the on-treatment period., Part 2 and 3: Duration of objective response (DOR) based on blinded independent central review., Part 2 and 3: Progression-free survival (PFS) based on blinded independent central review., Part 2 and 3: Disease control (DC) based on blinded independent central review., Part 2: Occurrence of treatment-emergent adverse events (TEAEs) during the on-treatment period.

Source: https://euclinicaltrials.eu/ctis-public/view/2023-504247-13-00